EU clinical trial 2023-505805-18-00: Phase 3, Open-label, Single-dose, Multicenter Study Investigating Efficacy, Safety, and Tolerability of CSL222 (Etranacogene Dezaparvovec) Administered to Adolescent Male Subjects (≥ 12 to < 18 Years of Age) with Severe or Moderately Severe Hemophilia B
Protocol code: CSL222_3004
Sponsor: CSL Behring LLC (Pharmaceutical company). Phase: Therapeutic confirmatory (Phase III). Countries: Belgium (ongoing, recruiting), Austria (authorised, recruitment pending), France (authorised, recruitment pending), Spain (authorised, recruitment pending).
Therapeutic area(s): Diseases [C] - Hemic and Lymphatic Diseases [C15]
Gender: Male. Age: 0-17 years. Enrolment: 6.
Start date (EU): 2026-05-27. Decision date: 2025-07-15. Results received: No. Last updated: 2026-07-03.
Decision dates by country: BE: 2025-07-15, ES: 2025-07-17, AT: 2025-07-21, FR: 2025-07-21

Condition(s): Hemophilia B
Product: Hemgenix 1x10^13 genome copies/mL concentrate for solution for infusion

Primary endpoint: Annualized Bleeding Rate (ABR)
Endpoint(s): 1. Canadian Hemophilia Outcomes-Kids Life Assessment Tool (CHO-KLAT) total score and change from baseline. At baseline and Month 18 post treatment., 2. Endogenous FIX activity, 3. Change from baseline in endogenous FIX activity, 4. Annualized consumption of FIX replacement therapy, 5. Annualized infusion rate of FIX replacement therapy, 6. Number of participants remaining free of continuous FIX prophylaxis, 7. Percentage of participants remaining free of continuous FIX prophylaxis, 8. ABR for spontaneous, joint, and FIX-treated bleeding episodes, 9. Correlation of FIX activity levels and pre-CSL222 AAV5 NAb titer, 10. Number of new target joints and resolution of preexisting target joints, 11. Number of participants with zero bleeds and zero FIX-treated bleeds, 12. Percentage of participants with zero bleeds and zero FIX-treated bleeds, 13. Change in the EuroQol-5 Dimensions-5 Levels (EQ-5D-5L) Visual Analogue Scale (VAS) Overall Score, 14. Change in the EQ-5D-5L Index Scores, 15. Change in the Patient-Reported Outcomes Measurement Information System (PROMIS)-25 total score, 16. Change from baseline in PROMIS-29 total score. At baseline, during the Lead-In Period (at least 6 months), and in the Posttreatment Follow-up Period (up to 5 years)., 17. Number of participants with endogenous FIX activity of => 5%, 18. Percentage of participants with endogenous FIX activity of => 5%, 19. Adverse events - number of participants, 20. Adverse events - percentage of participants, 21. Adverse events - number of events, 22. Change in liver ultrasound, 23. Number of participants with antibodies against AAV5, 24. Number of participants who develop FIX inhibitors, 25. Number of clinically significant clinical laboratory tests (Hematology and Biochemistry) reported as an AE, 26. Number of participants with clinically significant ALT/AST levels, 27. Percentage of participants with clinically significant ALT/AST levels, 28. Number of participants using corticosteroid for change in AST/ALT levels, 29. Duration of corticosteroid use for change in AST/ALT levels, 30. Mean inflammatory markers values, 31. Change from baseline in Inflammatory markers

Source: https://euclinicaltrials.eu/ctis-public/view/2023-505805-18-00